EU clinical trial 2024-516601-23-00: AAS-Lynch - Assessment of the effect of a daily chemoprevention by aspirin low-dose of new or recurrent colorectal adenomas in patients with Lynch syndrome
Protocol code: P130937
Sponsor: Assistance Publique Hopitaux De Paris (Hospital/Clinic/Other health care facility). Phase: Therapeutic confirmatory (Phase III). Countries: France (ongoing, recruitment ended).
Therapeutic area(s): Diseases [C] - Neoplasms [C04]
Gender: Female, Male. Age: 18-64 years, 65+ years. Enrolment: 852.
Status: Ongoing, recruitment ended. Start date (EU): 2017-11-14. Decision date: 2024-09-25. Results received: No. Last updated: 2025-03-13.

Condition(s): Colorectal adenomas, Lynch syndrome
Product: Aspirin® protect 100 mg Magensaftresistente Tablette Acetylsalicylsäure, Aspirin® protect 300 mg Magensaftresistente Tablette Acetylsalicylsäure, Placebo of Aspirine 100 mg protect, placebo of aspirin 300 mg protect

Primary endpoint: Number of patients with at least 1adenoma on chromoendoscopy 48months after complete withdrawal of polyps and initiation of IMP. Only neoplastic polyps (progress to cancer), defined by the following histological types as determined by ACP result, will be considered: 1) Adenoma not otherwise specified 2) Tubular adenoma 3) Tubulovillous adenoma 4) Mixed or serrated adenoma (sessile serrated adenoma) 5) Villous adenoma. Additionally, cancers will also be considered for primary endpoint analysis
Endpoint(s): Delay between the onset of 1 adenoma after complete resection of polyps and date of start of treatment (aspirin vs placebo), Number of patients who presented an adenoma during follow-up based on the gene reached (MLH1, MSH2, MSH6, PMS2, or without other identified anomalies), Load serrated polyps after 24 and 48 months of treatment, Adenomatous polyp burden, measured by chromoendoscopy as the sum of the size of all adenomatous polyps as a function of the dose of ASA (100 or 300 mg), Load measured by polyps chromoendoscopy as the sum of the size of all polyps according to the aspirin dose (100 or 300mg), Colon cancers diagnosed during the scheduled surveillance colonoscopies, Time to onset of colon cancer diagnosed during the scheduled surveillance colonoscopies, Cancers of the colon interval (diagnosed between 2 surveillance colonoscopies programmed), Time to onset of interval colorectal cancer, Number of colonoscopies performed during follow-up in study, Quality of preparation before colonoscopy, Chromoendoscopy expected execution, Counting of remaining tablets in blisters, Number of events or side effects, Food frequency, Distribution of the bacterial population based on two groups (treated / untreated) and recidivism, Distribution of polymorphisms based on 2 groups (treated / untreated) and recidivism, Proportion of patients with at least one adenoma seen on chromo-endoscopy within 48 months after complete polyp resection and the start of treatment (aspirin vs placebo)

Source: https://euclinicaltrials.eu/ctis-public/view/2024-516601-23-00